EU clinical trial 2024-516566-11-00: Impact of microglial activation on synaptic density in Alzheimer’s disease
Protocol code: D23-P006
Sponsor: Groupe Hospitalier Universitaire Paris Psychiatrie Et Neuroscience (Hospital/Clinic/Other health care facility). Phase: Therapeutic exploratory (Phase II). Countries: France (ongoing, recruitment ended).
Therapeutic area(s): Diseases [C] - Nervous System Diseases [C10]
Gender: Female, Male. Age: 18-64 years, 65+ years. Enrolment: 90.
Status: Ongoing, recruitment ended. Start date (EU): 2024-11-29. Decision date: 2024-11-29. Results received: No. Last updated: 2025-10-15.

Condition(s): Alzeihmer disease
Product: 11C-UCB-J, 18F-DPA-714, [11C]PiB

Primary endpoint: The degree of correlation at baseline between [18F]-DPA-714, [18F]-Ro948, and [11C]-UCB-J expressed in SUVr will be assessed with Kendall's Tau test
Endpoint(s): The multivariate approach of the Mixed Model Repeated Measures (MMRM) will be used to evaluate the longitudinal evolution of clinical and instrumental parameters collected. Analyses will be adjusted for clinical and demographic characteristics at baseline.

Source: https://euclinicaltrials.eu/ctis-public/view/2024-516566-11-00